EU clinical trial 2024-519191-90-00: A Phase II Trial of Teclistamab in participants with previously treated Immunoglobulin Light-Chain (AL) Amyloidosis
Protocol code: EMN40
Sponsor: European Myeloma Network B.V., Emn Trial Office S.r.l. Impresa Sociale (Patient organisation/association, Laboratory/Research/Testing facility). Phase: Therapeutic exploratory (Phase II). Countries: Greece (ongoing, recruitment ended), Italy (ongoing, recruitment ended), France (ongoing, recruitment ended), Germany (ongoing, recruitment ended), Netherlands (ongoing, recruitment ended).
Therapeutic area(s): Diseases [C] - Neoplasms [C04]
Gender: Female, Male. Age: 18-64 years, 65+ years. Enrolment: 24.
Status: Ongoing, recruitment ended. Start date (EU): 2025-07-02. Decision date: 2025-04-22. Results received: No. Last updated: 2026-07-07.
Decision dates by country: IT: 2025-04-23, GR: 2025-04-24, FR: 2025-04-22, DE: 2025-04-25, NL: 2025-04-24

Condition(s): Immunoglobulin Light-Chain (AL) Amyloidosis
Product: teclistamab, teclistamab

Primary endpoint: The hematologic CR rate at the completion of 3 cycles (M3) of teclistamab, according to current criteria for response in AL amyloidosis.
Endpoint(s): • The hematologic ORR, defined as the proportion of patients achieving a best hematologic response of PR or better, at the completion of 1 (M1), 3 (M3), and 6 cycles (M6), and every 3 months thereafter., • The VGPR rate, defined as the proportion of patients achieving a best hematologic response of VGPR or better, at the completion of 1 (M1), 3 (M3), and 6 cycles (M6), and every 3 months thereafter., • The duration of hematologic response, defined as the time from the date of initial documentation of hematologic PR, VGPR, or CR, to the date of first documented evidence of hematologic progressive disease (PD). For patients who have not progressed, data will be censored at the last disease assessment., • The rate of organ response according to standard criteria, defined as the proportion of patients achieving an organ response among patients with corresponding organ involvement, at the completion of 1 (M1), 3 (M3) and 6 cycles (M6), and every 3 months thereafter. For heart and kidney, the depth of response will be presented at the completion of 1 (M1), 3 (M3) and 6 cycles (M6), and every 3 months thereafter, based on the criteria mentioned on Table 16, • The time to hematologic response, defined as the time from the date of C1D1 to the date of the first efficacy evaluation during which the patient has met all criteria for hematologic PR, VGPR or CR. Patients without a hematologic response will be censored, either at the date of PD or, in the absence of PD, at the last evaluable disease assessment., • The hemPFS, defined as the time from the date of C1D1 to the date of first documentation of hematologic PD, or death due to any cause, whichever occurs first. Patients who are still alive and not yet progressed will be censored at the last disease assessment., • The MOD-PFS, defined as the time from the date of C1D1 to hematologic PD, manifestation of cardiac/renal failure, or death, whichever occurs first. For alive and MOD-PFS-free patients, censoring will be considered at the last adequate disease assessment., • The MOD-EFS, defined as the time from the date of C1D1 to hematologic PD, manifestation of cardiac/renal failure, initiation of subsequent therapy for amyloidosis, or death, whichever occurs first. For alive and MOD-EFS-free patients, censoring will be considered at the last adequate disease assessment., • The TST, defined as the time from the date of C1D1 to the date of initiation of subsequent therapy. Death due to PD (including cardiac/renal failure as per MOD-PFS definition) without the start of subsequent therapy will be considered as an event. Patients who withdrew trial consent, were lost to follow-up or died due to causes other than PD, will be censored at the date of death or at the date last known to be alive., • The OS, defined as the time from the date of C1D1 to the date of patient’s death. Patients who are alive or with unknown vital status will be censored at the date last known to be alive., • The safety and tolerability of teclistamab, by type, frequency, severity, relationship of adverse events to trial treatment, and changes in vital signs and physical exams., • The MRD negativity rate by NGF or NGS, according to local routine practices, defined as the proportion of patients achieving negative MRD at the completion of 3 cycles of treatment with Teclistamab and at the end of treatment., • The changes in QoL using EORTC QLQ30, EQ-5D-5L, and SF-36v2.

Source: https://euclinicaltrials.eu/ctis-public/view/2024-519191-90-00